EU clinical trial 2025-521587-35-00: A Randomized, Active-Controlled, Double-blind, Multicenter, Phase 3 Clinical Study of Ivonescimab in Combination with FOLFOX versus Bevacizumab in Combination with FOLFOX for the First-line Treatment of Metastatic Colorectal Cancer (HARMONi-GI3)
Protocol code: SMT112-3005
Sponsor: Summit Therapeutics Inc. (Pharmaceutical company). Phase: Therapeutic confirmatory (Phase III). Countries: Belgium (authorised, recruiting), Italy (ongoing, recruiting), Spain (ongoing, recruiting), Germany (ongoing, recruiting), France (ongoing, recruiting), Poland (ongoing, recruiting), Czechia (ongoing, recruiting), Hungary (authorised, recruiting).
Therapeutic area(s): Diseases [C] - Neoplasms [C04]
Gender: Female, Male. Age: 18-64 years, 65+ years. Enrolment: 220.
Start date (EU): 2026-06-03. Decision date: 2026-02-12. Results received: No. Last updated: 2026-08-07.
Decision dates by country: FR: 2026-02-16, DE: 2026-02-13, ES: 2026-02-12, PL: 2026-02-16, BE: 2026-02-13, HU: 2026-02-16, IT: 2026-02-12, CZ: 2026-02-12

Condition(s): Metastatic colorectal cancer
Product: BEVACIZUMAB, FOLINIC ACID, FLUOROURACIL, ivonescimab, OXALIPLATIN

Primary endpoint: PFS by IRRC based on RECIST v1.1
Endpoint(s): OS, ORR and DOR as assessed by IRRC based on RECIST v1.1, Safety assessment: incidence and severity of adverse events (AEs), clinically significant abnormal laboratory test results, Pharmacokinetic profile: Serum concentrations of ivonescimab in patients at different time points after ivonescimab administration, Immunogenicity assessment: Number and percentage of patients with detectable anti-ivonescimab antibody

Source: https://euclinicaltrials.eu/ctis-public/view/2025-521587-35-00